EU clinical trial 2024-518250-16-00: A RandomIzed, Double-Blind, Placebo-CoNtrolled, Two-Part Study to Evaluate the Pharmacodynamic EffIcacy and Clinical Benefit of AT 007 in Patients with SoRbitol Dehydrogenase (SORD) DEficiency
Protocol code: AT-007-1005
Sponsor: Applied Therapeutics Inc. (Pharmaceutical company). Phase: Phase II and Phase III (Integrated). Countries: Czechia (ended), Italy (ended).
Therapeutic area(s): Diseases [C] - Nervous System Diseases [C10]
Gender: Female, Male. Age: 0-17 years, 18-64 years. Enrolment: 45.
Status: Ended. Start date (EU): 2022-10-20. End date (EU): 2026-04-29. End date: 2026-05-04. Decision date: 2025-01-13. Results received: No. Last updated: 2025-12-18.
Decision dates by country: IT: 2025-01-21, CZ: 2025-01-13

Condition(s): Sorbitol Dehydrogenase (SORD) Deficiency
Product: AT-007, AT-007 Placebo, oral suspension

Primary endpoint: Change from baseline to Month 12 in the level of blood sorbitol, Change from baseline to Month 24 on the 10MWRT
Endpoint(s): Change from baseline to Month 12 on the 10MWRT, Change from baseline to Month 12 on CMT-FOM total and subdomain scores, Change from baseline to Month 12 on CMTHI score, Correlation between change in sorbitol and changes in all clinical outcomes, Change from baseline to Month 12 in the percentage of fat in lower extremity muscle as assessed by MRI, Change from baseline to Month 24 on CMTHI score, Change from baseline to Month 24 on the CMT-FOM total and subdomain scores, Change from baseline to Month 24 in the level of blood sorbitol and correlation with all clinical outcomes, Change from baseline to Month 24 in the percentage of fat in lower extremity muscle as assessed by MRI (only if Month 12 between-group difference [AT-007 minus placebo] is not statistically significant), Assessment of the patients’ perspective on the impact of disease on their lives and the benefit or perceived harm during the study with an “exit interview”

Source: https://euclinicaltrials.eu/ctis-public/view/2024-518250-16-00